EU clinical trial 2024-520427-86-00: Phase I, open-label clinical trial to evaluate the safety and clinical response of repeated-dose intra-arterial infusion of autologous mesenchymal cells in children and adolescents with refractory epilepsies.
Protocol code: Rasmusscell
Sponsor: Fundacion Para La Investigacion Biomedica Del Hospital Universitario La Princesa (Laboratory/Research/Testing facility). Phase: Human Pharmacology (Phase I)- First administration to humans. Countries: Spain (ongoing, recruiting).
Therapeutic area(s): Diseases [C] - Nervous System Diseases [C10]
Gender: Female, Male. Age: 0-17 years. Enrolment: 10.
Status: Ongoing, recruiting. Start date (EU): 2025-01-24. Decision date: 2025-01-24. Results received: No. Last updated: 2025-01-24.

Condition(s): Autoimmune refractory epilepsy and Rasmussen Encephalitis
Product: AloCelyvir

Primary endpoint: To measure dose-limiting toxicities (DLTs, defined in the protocol as MSC infusion-related grade 3 toxicities occurring in the first 28 days of treatment).
Endpoint(s): To asses clinical response

Source: https://euclinicaltrials.eu/ctis-public/view/2024-520427-86-00